EU clinical trial 2024-512261-14-00: A Phase 2, Randomized, Double-Blind, Placebo-Controlled, Multicenter Study to Evaluate the Safety and Efficacy of Vosoritide in Infants and Young Children with Hypochondroplasia, Aged 0 to < 36 Months
Protocol code: 111-212
Sponsor: Biomarin Pharmaceutical Inc. (Pharmaceutical company). Phase: Therapeutic exploratory (Phase II). Countries: Germany (ongoing, recruiting), Italy (ongoing, recruiting), France (ongoing, recruiting).
Therapeutic area(s): Phenomena and Processes [G] - Genetic Phenomena [G05]
Gender: Female, Male. Age: 0-17 years. Enrolment: 30.
Status: Ongoing, recruiting. Start date (EU): 2025-12-22. Decision date: 2025-10-20. Results received: No. Last updated: 2026-06-26.
Decision dates by country: DE: 2025-10-21, IT: 2025-10-20, FR: 2025-10-31

Condition(s): Hypochondroplasia
Product: Voxzogo 0.56 mg powder and solvent for solution for injection, powder and solvent for solution for injection

Primary endpoint: • Incidence of TEAEs versus placebo over the course of the study, • Incidence of SAEs versus placebo over the course of the study, • Changes in standard clinical laboratory values (urinalysis, chemistry, hematology) versus placebo over the course of the study, • Changes in vital signs versus placebo over the course of the study, • Change from baseline at Week 52 versus placebo in height Z-score
Endpoint(s): Change (Chg) baseline (bl) – Week (W)52 vs placebo (plcb) in height, 6-month interval AGV at W52 vs plcb, Chg bl - W52 vs plcb in upper to lower body segment ratio, Chg bl - W52 vs plcb in arm span, Chg bl - W52 vs plcb in total body BMD Zscore by DXA, Chg bl - W52 vs plcb in lumbar spine BMD Zscore by DXA, Chg bl - W52 vs plcb in tot. body BMC by DXA, Chg bl - W52 vs plcb in lumbar spine BMC by DXA, PK, Chg from pre-dose vs plcb in cGMP, Incidence of otitis media vs plcb, Seizure freq. vs plcb

Source: https://euclinicaltrials.eu/ctis-public/view/2024-512261-14-00